EU clinical trial 2024-516418-39-00: A phase 3, open-label, controlled, randomized study of newly diagnosed multiple myeloma treatment, designed to evaluate the efficacy and safety of the elranatamab-lenalidomide combination as a replacement for chemotherapy followed by autologous stem cell transplant in the consolidation phase, and to compare elranatamab with standard of care in the maintenance phase (ElLen; IFM 2025-01)
Protocol code: IFM2025-01
Sponsor: Intergroupe Francophone Du Myelome (Patient organisation/association). Phase: Therapeutic confirmatory (Phase III). Countries: France (ongoing, recruiting).
Therapeutic area(s): Diseases [C] - Neoplasms [C04]
Gender: Female, Male. Age: 18-64 years, 65+ years. Enrolment: 824.
Status: Ongoing, recruiting. Start date (EU): 2025-07-09. Decision date: 2025-05-05. Results received: No. Last updated: 2026-07-10.

Condition(s): Multiple Myeloma
Product: DARZALEX 1800 mg solution for injection, ELREXFIO 40 mg/mL solution for injection, Lenalidomide 25mg hard capsules, Bortezomib 3.5 mg powder for solution for injection, Lenalidomide 10mg hard capsules, Dexamethasone 20 mg tablets, Privigen 100 mg/ml solution for infusion, ELREXFIO 40 mg/mL solution for injection

Primary endpoint: MRD negativity rate as determined by NGS with a sensitivity of at least 10-5 measured at end of consolidation, PFS R2 defined as the time interval from the date of second randomization to the date of confirmed PD (IMWG criteria) or death from any cause, whichever occurs first.
Endpoint(s): PFS R1 defined as the time interval from the date of first randomization to the date of confirmed PD (IMWG criteria) or death from any cause, whichever occurs first., OS R1 defined as the time interval from the date of first randomization to the date of death from any cause, - Overall response rate (ORR) - Very good partial response (VGPR) rate - Complete response (CR) rate - Sustained MRD negativity rate at 24 months defined as the proportion of participants with CR per IMWG criteria and MRD negativity at 12 months after R1 which is sustained at 24 months after R1, - Overall response rate (ORR) in maintenance - Very good partial response (VGPR) rate in maintenance - Complete response (CR) rate in maintenance - PFS of subsequent/next treatment line (PFS2 from R2) - Overall survival from second randomization (OS R2), Incidence and severity of AEs, QoL will be assessed using the following instruments: • EORTC QLQ-C30, • EUROQOL (EQ-5D-5L) • Return to work questionnaires

Source: https://euclinicaltrials.eu/ctis-public/view/2024-516418-39-00